EU clinical trial 2023-504893-39-00: Dopaminergic disruption induced by traumatic coma: multimodal neuroimaging approaches to characterize dopaminergic pathways abnormalities and biomarkers of recovery using the [18F]LBT-999 radiotracer.
Protocol code: C22-62
Sponsor: Institut National De La Sante Et De La Recherche Medicale (Laboratory/Research/Testing facility). Phase: Phase II and Phase III (Integrated). Countries: France (ongoing, recruiting).
Therapeutic area(s): Phenomena and Processes [G] - Musculoskeletal and Neural Physiological Phenomena [G11]; Analytical, Diagnostic and Therapeutic Techniques and Equipment [E] - Investigative Techniques [E05]
Gender: Female, Male. Age: 18-64 years. Enrolment: 55.
Status: Ongoing, recruiting. Start date (EU): 2025-01-14. Decision date: 2024-04-22. Results received: No. Last updated: 2025-04-04.

Condition(s): Comatose Traumatic Brain Injury patients
Product: 18F-LBT-999

Primary endpoint: To characterize metabolic abnormalities in the dopaminergic network of patients in the TC-COMA group, the level of [18F]LBT-999 binding to presynaptic dopamine membrane transporters located in the striatum (caudate nuclei and putamen), assessed during PET scans of these patients, will be compared with that of subjects in the control group. This level of binding will be expressed by the average Binding potential (BP) in the striatum.
Endpoint(s): The level of [18F]LBT-999 binding to presynaptic membrane dopamine transporters located throughout the dopaminergic network and brainstem in the patients in the TC-COMA group and subjects in the control group will be assessed by PET scan. This level of binding will be expressed by the mean BP and by the Standard Uptake Value ratio (SUV-r) within each region of interest (ROI) of the dopaminergic network (i.e. striatum, pallidum, substantia nigra) and brainstem, and compared between the groups;, The level of [18F]LBT-999 binding to presynaptic membrane dopamine transporters located at the ROIs defined above and expressed by BP and SUV-r, in patients in the TC-COMA group will be compared to that of patients in the TC-ROS group., The links between metabolic changes in the dopaminergic network and structural changes on the one hand, and functional changes on the other, will be established on the basis of parameters collected by PET and MRI in all TC patients (TC-COMA and TC-ROS): o Metabolic changes in the dopaminergic network o Structural changes in white matter o Structural changes in gray matter o Functional changes, Motor behavioral signatures will be assessed in all patients (TC-COMA and TC-ROS) and expressed by the score obtained on the MDS-UPDRS scale., Patients' neurological outcome will be assessed at 3 months, 6 months and 1 year after CT using the CRS-R and DRS (Disability Rating Scale) (35); quality of life using the QOLIBRI

Source: https://euclinicaltrials.eu/ctis-public/view/2023-504893-39-00